EU clinical trial 2024-512229-10-00: INTOReTAK - Multicentre, randomized, prospective trial evaluating the efficacy and safety of Infliximab to tocilizumab in refractory or relapsing Takayasu arteritis - INTOReTAK : INfliximab and TOcilizumab in Refractory/relapsing TAKayasu arteritis
Protocol code: P160909
Sponsor: Assistance Publique Hopitaux De Paris (Hospital/Clinic/Other health care facility). Phase: Therapeutic exploratory (Phase II). Countries: France (ongoing, recruiting).
Therapeutic area(s): Diseases [C] - Cardiovascular Diseases [C14]
Gender: Female, Male. Age: 0-17 years, 18-64 years, 65+ years. Enrolment: 50.
Status: Ongoing, recruiting. Start date (EU): 2021-02-04. Decision date: 2024-09-16. Results received: No. Last updated: 2026-02-19.

Condition(s): Takayasu arteritis
Product: INFLIXIMAB, RoActemra 20 mg/mL concentrate for solution for infusion

Primary endpoint: Proportion at 6 months after Day1 of treatment, of patients with prednisone (or the prednisolone) ≤ 0.1mg/kg per day and sustained inactive disease from M3 to M6 and same biological therapy from Day1 of treatment among the randomized patients in the same arm.
Endpoint(s): • Incidence of relapse as defined by the NIH criteria between M3 and M6 after Day1 of treatment., • Incidence of traitement failure at M3 after Day1 of treatment i.e disease still active according to the NIH criteria, • Proportion at 6 months after Day1 of treatment of patients with prednisone (or the prednisolone) ≤ 0.1mg/kg per day and sustained inactive disease (modified NIH score (without criterion 3) ≤ 1) from M3 to M6 and same biological therapy from Day1 of treatment among the randomized patients in the same arm., • Incidence of relapse as defined by the modified NIH criteria (without criterion 3) ≥2 between M3 and M6 after Day1 of treatment., • incidence of traitement failure at M3 after Day1 of treatment i.e disease still active according to the modified NIH criteria (without criterion 3) ≥2, • Incidence of revascularization procedures (endovascular or surgical) from Day1 of treatment to M6 and M12 after Day1 of treatment, • Cumulative doses of prednisone (or the prednisolone) in each arm at M6 and M12 after Day1 of treatment, • Incidence of adverse events of grades III or IV at M6 and M12 after Day1 of treatment, • Mean change in the quality of life questionnaire SF-36 from D1 of treatment to M6 and M12 after treatment, • Proportion of new vascular lesions at M6 and M12 after Day1 of treatment assessed by angio-CT or MR angiography

Source: https://euclinicaltrials.eu/ctis-public/view/2024-512229-10-00